EU clinical trial 2025-521401-41-00: A Study to Evaluate the Effect of RO7204239 on Insulin Sensitivity and Muscle Composition in Participants with Type 2 Diabetes Mellitus(T2DM) and Overweight or Obesity
Protocol code: BP45980
Sponsor: F. Hoffmann-La Roche AG (Pharmaceutical company). Phase: Human Pharmacology (Phase I)- Other. Countries: Germany (ongoing, recruitment ended).
Therapeutic area(s): Diseases [C] - Nutritional and Metabolic Diseases [C18]
Gender: Female, Male. Age: 18-64 years, 65+ years. Enrolment: 30.
Status: Ongoing, recruitment ended. Start date (EU): 2025-09-08. Decision date: 2025-08-15. Results received: No. Last updated: 2026-07-30.

Condition(s): Type 2 Diabetes Mellitus (T2DM) and overweight or obesity

Source: https://euclinicaltrials.eu/ctis-public/view/2025-521401-41-00